EU clinical trial 2024-513734-38-00: BRCA-P: A Randomized, Double-Blind, Placebo-Controlled, Multi-Center, International Phase 3 Study to Determine the Preventive Effect of Denosumab on Breast Cancer in Women Carrying a BRCA1 Germline Mutation
Protocol code: BRCA-P/ABCSG 50
Sponsor: Verein Zur Praevention Und Therapie Boesartiger Erkrankungen Austrian Breast And Colorectal Cancer Study Group, Institut Catala D'oncologia, ANZ Breast Cancer Trials Group Limited, University Of Manchester, Alliance Foundation Trials LLC, Shaare Zedek Medical Center (Patient organisation/association, Hospital/Clinic/Other health care facility, Laboratory/Research/Testing facility, Educational Institution, Pharmaceutical company, Hospital/Clinic/Other health care facility). Phase: Therapeutic confirmatory (Phase III). Countries: Spain (ongoing, recruiting), Germany (ongoing, recruiting), Austria (ongoing, recruiting).
Therapeutic area(s): Diseases [C] - Neoplasms [C04]
Gender: Female. Age: 18-64 years. Enrolment: 1150.
Status: Ongoing, recruiting. Start date (EU): 2019-07-03. Decision date: 2024-08-14. Results received: No. Last updated: 2025-07-24.
Decision dates by country: AT: 2024-08-20, ES: 2024-08-14, DE: 2024-08-16

Condition(s): Prevention of breast cancer in women with a BRCA1 germline mutation
Product: Identical to the Test product, XGEVA 120 mg solution for injection

Primary endpoint: Time to the occurrence of any breast cancer (invasive or DCIS)
Endpoint(s): Time to invasive breast cancer, Time to invasive triple negative breast cancer, Time to ovarian, fallopian tube or primary peritoneal cancer (in women who have not undergone PBSO), Time to other (non breast or ovarian cancer) malignancies, including those known to be associated with BRCA1 mutations, Time to clinical fractures in pre- and postmenopausal women, Frequency of breast biopsies and frequency of benign breast lesions

Source: https://euclinicaltrials.eu/ctis-public/view/2024-513734-38-00